EU clinical trial 2023-507215-35-00: Influence of Dexmedetomidine on the Human Glymphatic Cerebrospinal Fluid Flow, Neural Activity and Cerebral Blood Flow in Functional Magnetic Resonance Imaging (GlymphDex)
Sponsor: Helsinki University Central Hospital (Hospital/Clinic/Other health care facility). Phase: Therapeutic exploratory (Phase II). Countries: Finland (authorised, recruitment pending).
Therapeutic area(s): Analytical, Diagnostic and Therapeutic Techniques and Equipment [E] - Anesthesia and Analgesia [E03]
Gender: Female, Male. Age: 18-64 years. Enrolment: 20.
Status: Authorised, recruitment pending. Decision date: 2023-09-25. Results received: No. Last updated: 2026-02-16.

Condition(s): Neurodegenerative disease; Delirium; Acute neurological disease
Product: Dexdor 100 micrograms/ml concentrate for solution for infusion

Primary endpoint: The primary outcome is the change in functional magnetic resonance signals or power spectra reflecting neural activity, brain pulsation, cerebral blood flow, and CSF flow with changing states of consciousness.
Endpoint(s): • Change in any MRI signal with drug concentrations, different states of consciousness, sedation-related EEG changes, and blood biomarkers., • Influence of physiological parameters on MRI signals, biomarkers, and EEG., • Comparison of regional and tissue specific differences in MRI between different states of consciousness and with different levels of sedation., • Correlation between MRI data, EEG data and peripheral blood biomarkers with sleep quality on the previous night., • Correlation of dexmedetomdine sedation with levels of biomarkers, particularly plasma sodium, plasma osmolality, blood glucose, serum insulin, plasma copeptin and serum cortisol levels., • Creating a model for glymphatic CSF flow in functional MRI (i.e. typical functional MRI signal/spectra).

Source: https://euclinicaltrials.eu/ctis-public/view/2023-507215-35-00